EU clinical trial 2024-520043-17-00: The impact of Thromboprophylaxis on Progression Free Survival of Patients with Advanced Pancreatic Cancer. The Pancreatic Cancer & Tinzaparin Prospective (imPaCT-PRO) study
Protocol code: imPaCT-PRO-01
Sponsor: Institute Of Molecular Medicine And Biomedical Research (Laboratory/Research/Testing facility). Phase: Therapeutic confirmatory (Phase III). Countries: Greece (authorised, recruitment pending).
Therapeutic area(s): Diseases [C] - Neoplasms [C04]
Gender: Female, Male. Age: 18-64 years. Enrolment: 450.
Status: Authorised, recruitment pending. Decision date: 2025-01-23. Results received: No. Last updated: 2025-01-23.

Condition(s): Thromboprophylaxis in patients with advanced pancreatic cancer
Product: innohep® 10.000 anti Xa IU/0,5mL PF.SYR. Ενέσιμο διάλυμα, innohep® 18.000 anti Xa IU/0,9mL PF.SYR. Ενέσιμο διάλυμα, innohep® 14.000 anti Xa IU/0,7mL PF.SYR. Ενέσιμο διάλυμα

Primary endpoint: PFS of patients receiving thromboprophylaxis with tinzaparin, in comparison with the PFS of patients not receiving such prevention (primary endpoint)., All objectively confirmed VTE events during the study per treatment arm including symptomatic distal deep vein thrombosis (DVT), symptomatic or incidental proximal DVT (including iliac and cava thrombosis), symptomatic or incidental pulmonary embolism (PE) or both DVT and PE (co-primary endpoint) or fatal PE or vein thrombosis of rare localisation (i.e., splanchnic vein or cerebral vein thrombosis).
Endpoint(s): % of patients experiencing at least one major bleeding event, according to the International Society on Thrombosis and Haemostasis (ISTH) criteria during the study per treatment arm., % of patients experiencing any bleeding event, including major, clinically relevant non-major bleeding (CRNMB) and minor bleeding events during the study per treatment arm., Incidence of VTE events, per event type, during the study per treatment arm., ORR, defined as the percentage of patients with complete response (CR) or partial response (PR) based on RECIST criteria., Change from baseline in QoL at 4 months and 10 months per treatment arm., Overall Survival (OS) of patients receiving tinzaparin thromboprophylaxis compared to OS of patients not receiving such prophylaxis.

Source: https://euclinicaltrials.eu/ctis-public/view/2024-520043-17-00